EU clinical trial 2024-511178-66-00: An Open-Label Extension Study to Evaluate the Long-Term Safety and Efficacy of Once Daily Mexiletine PR in Patients with Myotonic Dystrophy Type 1 and Type 2 who have completed the MEX-DM-302 Study.
Protocol code: MEX-DM-303
Sponsor: Lupin Atlantis Holdings SA (Pharmaceutical company). Phase: Therapeutic confirmatory (Phase III). Countries: Belgium (ongoing, recruiting), Italy (ongoing, recruiting), Germany (ongoing, recruiting), Denmark (ongoing, recruiting), Spain (ongoing, recruiting).
Therapeutic area(s): Phenomena and Processes [G] - Musculoskeletal and Neural Physiological Phenomena [G11]
Gender: Female, Male. Age: 0-17 years, 18-64 years, 65+ years. Enrolment: 146.
Status: Ongoing, recruiting. Start date (EU): 2025-09-12. Decision date: 2024-10-07. Results received: No. Last updated: 2026-05-28.
Decision dates by country: DK: 2024-10-07, ES: 2024-10-08, DE: 2024-10-09, BE: 2024-10-11, IT: 2024-10-09

Condition(s): Myotonic Dystrophy type 1 and type 2 (DM1/DM2)
Product: Mexiletine granules for prolonged-release oral suspension 333 mg, Mexiletine granules for prolonged-release oral suspension 167 mg, Mexiletine granules for prolonged-release oral suspension 500 mg

Primary endpoint: Incidence of Treatment Emergent Adverse Events (TEAEs), treatment-related TEAEs, serious AEs, and patient discontinuation rate., Standard clinical laboratory evaluations, physical examinations, and vital signs, Mean change from baseline in PR, QRS, and QTc Intervals, and average minimum heart rate by 12-lead in ECG., Clinically relevant arrhythmic events in the Holter monitor results
Endpoint(s): Handgrip Dynamometer, Individualized Neuromuscular Quality of Life Questionnaire (INQoL) locking domain, Myotonia Behavior Scale (MBS), Visual Analog Scale (VAS) for myotonia, 10 meter Walk Test (10mWT), DM1-Active-c

Source: https://euclinicaltrials.eu/ctis-public/view/2024-511178-66-00